EU clinical trial 2023-506200-24-00: A Phase 3, Randomized, Double-blind, Placebo-controlled, Parallel-group Study of Carbetocin Nasal Spray for the Treatment of Hyperphagia in Prader-Willi Syndrome
Protocol code: ACP-101-302
Sponsor: Acadia Pharmaceuticals Inc. (Pharmaceutical company). Phase: Therapeutic confirmatory (Phase III). Countries: Spain (ended), Germany (ended), Italy (ended), Belgium (ended), France (ended).
Therapeutic area(s): Diseases [C] - Congenital, Hereditary, and Neonatal Diseases and Abnormalities [C16]
Gender: Female, Male. Age: 0-17 years, 18-64 years. Enrolment: 98.
Status: Ended. Start date (EU): 2025-01-10. End date (EU): 2025-08-19. End date: 2025-08-20. Decision date: 2024-05-28. Results received: Yes. Last updated: 2025-06-30.
Decision dates by country: BE: 2024-05-29, IT: 2024-05-31, ES: 2024-05-31, FR: 2024-05-31, DE: 2024-05-28

Condition(s): Hyperphagia related behaviour associated with Prader-Willi Syndrome (PWS)
Product: Carbetocin Nasal Spray, Placebo to match carbetocin 11.4 mg/ml (2ml /vial)

Primary endpoint: Hyperphagia Questionnaire for Clinical Trials (HQ-CT) score - change from Baseline at Week 12
Endpoint(s): Clinical Global Impression–Severity (CGI-S) for PWS score – change from Baseline at Week 12, Clinical Global Impression–Change (CGI-C) for PWS score at Week 12, Percentage of subjects with treatment response (defined as improvement from Baseline ≥8 points) based on the HQ-CT at Week 12, CGI-S for hyperphagia in PWS score – change from Baseline at Week 12

Source: https://euclinicaltrials.eu/ctis-public/view/2023-506200-24-00